EU clinical trial 2024-517166-42-00: A prospective multicenter phase 2 study of copanlisib in combination with rituximab and CHOP chemotherapy (COPA-R-CHOP) in patients with previously untreated diffuse large B-cell lymphoma (DLBCL)
Protocol code: UKM18-0021
Sponsor: Universitaetsklinikum Muenster AöR (Hospital/Clinic/Other health care facility). Phase: Therapeutic exploratory (Phase II). Countries: Germany (ended).
Therapeutic area(s): Diseases [C] - Neoplasms [C04]
Gender: Female, Male. Age: 18-64 years, 65+ years. Enrolment: 61.
Status: Ended. Start date (EU): 2020-05-29. End date (EU): 2025-05-03. Decision date: 2024-09-17. Results received: Yes. Last updated: 2025-02-12.

Condition(s): Diffuse large B-cell lymphoma (DLBCL)
Product: DOXORUBICIN, CYCLOPHOSPHAMIDE, VINCRISTINE, RITUXIMAB, PREDNISONE, BAY 80-6946

Primary endpoint: Safety run-in part: The primary endpoint is the recommended phase 2 dose after analysis of the first 12 patients treated. All patients: 2-year PFS with 95% CI of all patients treated.
Endpoint(s): Secondary endpoints for efficacy: OS, EFS, CR, PR, ORR, PD, DOR, rate of relapse, Outcome in molecular subtypes of DLBCL, Secondary endpoints for safety: Adverse events (AE), Serious AEs (SAE), Number of treatment related deaths, Incidence of secondary malignancies, Number and duration of therapy cycles, Cumulative doses of cyclophosphamide, doxorubicin, vincristine, rituximab and copanlisib

Source: https://euclinicaltrials.eu/ctis-public/view/2024-517166-42-00